EU clinical trial 2024-513703-13-00: A prospective, interventional, single-center, single-arm study to assess the effectiveness of Bempedoic acid to achieve LDL-cholesterol targets in patients following ST-elevation or Non-ST-elevation myocardial infarctions insufficiently treated with atorvastatin plus ezetimibe (HACOL-ACS)
Protocol code: HACOL-ACS
Sponsor: Medizinische Hochschule Hannover (Educational Institution). Phase: Therapeutic confirmatory (Phase III). Countries: Germany (ended).
Therapeutic area(s): Diseases [C] - Cardiovascular Diseases [C14]
Gender: Female, Male. Age: 18-64 years, 65+ years. Enrolment: 135.
Status: Ended. Start date (EU): 2023-06-30. End date (EU): 2026-06-11. Decision date: 2024-11-08. Results received: No. Last updated: 2025-02-11.

Condition(s): Coronary artery disease/myocardial infarction
Product: Nilemdo 180 mg film-coated tablets

Primary endpoint: Proportion of patients (%) in group A who successfully achieve the ESC LDL-C guideline targets (LDL-C < 55 mg/dl) following 8 weeks of treatment with the triple therapy of atorvastatin plus ezetimibe and additive bempedoic acid (180 mg/d) in the group of patients that did not reach the LDL-C guideline targets after 6 weeks of treatment with dual therapy including atorvastatin (at least 40 mg/d or equivalent) plus ezetimibe (10 mg/d).
Endpoint(s): Proportion of patients (%) who successfully achieve ESC LDL-C guideline targets (LDL-C < 55 mg/dl) after treatment with dual therapy including atorvastatin (at least 40 mg/d or equivalent) plus ezetimibe (10 mg/d) for 6 and for 14 weeks, Proportion of patients (%) who successfully achieve the ESC LDL-C guideline targets after 14 weeks of treatment., Proportion of patients (%) who achieve AHA/ACC guideline recommended treatment targets of LDL-C < 70 mg/dl after 14 weeks of treatment in the triple therapy group, Mean change from baseline to week 6 and to week 14 in LDL-C, total cholesterol, HDL-C, triglycerides, uric acid, creatine kinase, systolic and diastolic blood pressure, pulse, Proportion of non-compliant patients (%) taking less than 90% of the allocated study medication, Mean change from baseline to week 6 and to week 14 in Quality of Life

Source: https://euclinicaltrials.eu/ctis-public/view/2024-513703-13-00